EU clinical trial 2023-506824-96-00: Efficacy and safety of NNC6019-0001 at two dose levels in participants with transthyretin amyloid cardiomyopathy (ATTR CM).
Protocol code: NN6019-4940
Sponsor: Novo Nordisk A/S (Pharmaceutical company). Phase: Therapeutic exploratory (Phase II). Countries: Portugal (ended), Netherlands (ended), Germany (ended), Spain (ended), Czechia (ended), Italy (ended), France (ended).
Therapeutic area(s): Diseases [C] - Cardiovascular Diseases [C14]
Gender: Female, Male. Age: 18-64 years, 65+ years. Enrolment: 61.
Status: Ended. Start date (EU): 2023-05-23. End date (EU): 2025-04-30. End date: 2025-05-13. Decision date: 2023-10-13. Results received: Yes. Last updated: 2025-04-11.
Decision dates by country: DE: 2023-10-16, NL: 2023-10-13, CZ: 2023-11-14, IT: 2023-11-20, ES: 2023-10-16, PT: 2023-10-13, FR: 2023-11-28

Condition(s): The present study will include a population of patients with established ATTR CM.
Product: coramitug, Placebo (nnc6019-0001), coramitug

Primary endpoint: Change in 6-minute walk test (6MWT) from baseline (week 0) to visit 15 (week 52), Change in NT-proBNP from baseline (week 0) to visit 15 (week 52)
Endpoint(s): Change in myocardial extracellular volume (ECV) from baseline (week 0) to visit 15 (week 52), Change in Kansas City Cardiomyopathy Questionnaire (KCCQ) Clinical Summary Score (CSS) from baseline (week 0) to visit 15 (week 52), Change in neuropathy impairment score (NIS) (only hATTR patients) from baseline (week 0) to visit 15 (week 52), Change in troponin I from baseline (week 0) to visit 15 (week 52), Change in global longitudinal strain (GLS) on echocardiography from baseline (week 0) to visit 15 (week 52), Number of treatment emergent adverse events from baseline (week 0) to visit 16 (week 64), Time to occurrence of all-cause mortality from baseline (week 0) to visit 16 (week 64), Number of CV events comprising hospitalisation due to CV events or urgent heart failure visits (week 0) to visit 16 (week 64)

Source: https://euclinicaltrials.eu/ctis-public/view/2023-506824-96-00